EU clinical trial 2024-510877-67-00: Phase I/II randomized trial of LB-100 plus doxorubicin vs. doxorubicin alone in first line of advanced soft tissue sarcomas
Protocol code: Geis-74
Sponsor: Asoc Grupo Espanol De Investigacion En Sarcomas (Patient organisation/association). Phase: Phase I and Phase II (Integrated)- Bioequivalence Study. Countries: Spain (ended).
Therapeutic area(s): Diseases [C] - Neoplasms [C04]
Gender: Female, Male. Age: 18-64 years, 65+ years. Enrolment: 157.
Status: Ended. Start date (EU): 2024-05-14. End date (EU): 2025-11-13. Decision date: 2024-05-14. Results received: Yes. Last updated: 2025-10-15.

Condition(s): Phase I:Adult patients with centrally confirmed diagnosis of advanced/metastatic undifferentiated pleomorphic sarcoma, leiomyosarcoma, myxoid/and hypercellular myxoid liposarcoma, myxofibrosarcoma, NOS sarcoma, synovial sarcoma, fibrosarcoma, malignant peripheral nerve sheath tumor, epitheloid sarcoma, pleomorphic rhabdomyosarcoma, pleomorphic liposarcoma and angiosarcoma, high-grade uterine sarcomas (excluding those with BCOR or NTRK translocation). Phase II:Adult patients with centrally confirmed diagnosis of advanced/metastatic undifferentiated pleomorphic sarcoma or leiomyosarcoma.
Product: DOXORUBICINE TEVA 50 mg/25 ml, solution injectable

Primary endpoint: Phase I: The MTD of LB-100 in combination with doxorubicin will be determined by assessing adverse events according to CTCAE v5.0 and they will be used as a rule for escalating or diminishing dose levels according to the dose-limiting toxicities detailed in the protocol., Phase II: Progression-free survival (PFS) (according to central radiology review): Efficacy measured by median PFS according to RECIST v1.1. PFS for each patient is defined as the time in months from date of randomization to date of progression or to death due to any cause, whatever occurs first.
Endpoint(s): Phase I: Safety profile: Toxicity assessed by adverse events related to study drugs, detected through physical examinations and laboratory tests, and graded according to CTCAE v5.0., Phase I: Overall Response Rate (ORR) (according to central radiology review): Efficacy measured by the ORR, which is defined as the number of subjects with a Best Overall Response (BOR) of Complete Response (CR) or Partial Response (PR) divided by the number of response evaluable subjects (according to RECIST v1.1 and Choi). Choi evaluation is an exploratory task for central radiology review only., Phase I: Progression-free survival (PFS) (according to central radiology review): Efficacy measured by median PFS according to RECIST v1.1. PFS for each patient is defined as the time in months from date of enrollment to date of progression or death due to any cause, whatever occurs first., Phase I: Overall survival (OS): Efficacy measured by OS, which is defined as the time in months from date of enrollment to date of death due to any cause. OS will be censored on the last date a subject was known to be alive., Phase I: Quality of life: Assessed by using the EORTC QLQ-C30 questionnaire., Phase II: Overall Response Rate (ORR) (according to central radiology review): Efficacy measured by the ORR, which is defined as the number of subjects with a Best Overall Response (BOR) of Complete Response (CR) or Partial Response (PR) divided by the number of response evaluable subjects (according to RECIST v1.1 and Choi). Choi evaluation is an exploratory task for central radiology review only., Phase II: Overall survival (OS): Efficacy measured by OS, which is defined as the time in months from date of randomization to date of death due to any cause. OS will be censored on the last date a subject was known to be alive., Phase II: Safety profile: Toxicity assessed by adverse events related to study drugs, detected through physical examinations and laboratory tests, and graded according to CTCAE v5.0., Phase II: Quality of life: Assessed by using the EORTC QLQ-C30 questionnaire.

Source: https://euclinicaltrials.eu/ctis-public/view/2024-510877-67-00